EU clinical trial 2024-512830-13-00: Single dose pharmacokinetics of selective serotonin reuptake inhibitor sertraline in plasma of female anorexia nervosa patients and healthy volunteers after oral administration: an exploratory study
Sponsor: Medical University Of Vienna (Educational Institution). Phase: Human Pharmacology (Phase I)- Other. Countries: Austria (ongoing, recruiting).
Therapeutic area(s): Psychiatry and Psychology [F] - Behavior and Behavior Mechanisms [F01]
Gender: Female. Age: 18-64 years. Enrolment: 8.
Status: Ongoing, recruiting. Start date (EU): 2019-03-25. Decision date: 2024-05-21. Results received: No. Last updated: 2024-05-21.

Condition(s): anorexia nervosa

Source: https://euclinicaltrials.eu/ctis-public/view/2024-512830-13-00